EU clinical trial 2023-504876-12-00: A Phase 3, Multi-center, Randomized Withdrawal and Long-Term Extension Study of Ampreloxetine for the Treatment of Symptomatic Neurogenic Orthostatic Hypotension in Participants with Multiple System Atrophy
Protocol code: 0197
Sponsor: Theravance Biopharma Ireland Limited (Pharmaceutical company). Phase: Therapeutic confirmatory (Phase III). Countries: Denmark (ended), Spain (ended), Austria (ended), France (ended), Germany (ended), Italy (ended), Estonia (ended), Poland (ended), Portugal (ended), Belgium (ended), Hungary (ended).
Therapeutic area(s): Diseases [C] - Cardiovascular Diseases [C14]
Gender: Female, Male. Age: 18-64 years, 65+ years. Enrolment: 33.
Status: Ended. Start date (EU): 2023-10-25. End date (EU): 2026-06-08. Decision date: 2023-08-11. Results received: No. Last updated: 2026-02-20.
Decision dates by country: DE: 2023-08-15, DK: 2023-08-11, PL: 2023-08-17, PT: 2023-12-11, EE: 2023-08-14, AT: 2023-08-21, HU: 2024-05-14, BE: 2024-05-13, FR: 2023-08-11, ES: 2023-08-11, IT: 2023-08-17

Condition(s): Neurogenic Orthostatic Hypotension
Product: Ampreloxetine tablets prepared with the same composition as IMP, except for the drug substance ., AMPRELOXETINE, Gutron® Tabletten 2,5 mg

Primary endpoint: The primary study efficacy endpoint is the change in OHSA composite score at Week 8 during the double-blind RW period (Visit 9, Day 141)
Endpoint(s): Change from baseline in OHDAS item 1 (activities that require standing for a short time) at Week 8 post randomization (Visit 9, Day 141), Change from baseline in OHDAS item 3 (activities that require walking for a short time) at Week 8 post randomization (Visit 9, Day 141)

Source: https://euclinicaltrials.eu/ctis-public/view/2023-504876-12-00